EU clinical trial 2023-504963-17-00: A Multicenter, Open-label, Randomized, Phase 1/2 Study of Belzutifan in Combination with Palbociclib Versus Belzutifan Monotherapy in Participants with Advanced Renal Cell Carcinoma
Protocol code: MK-6482-024
Sponsor: Merck Sharp & Dohme LLC (Pharmaceutical company). Phase: Phase I and Phase II (Integrated)- Other. Countries: Sweden (ended), Poland (ended), France (ended), Germany (ended), Italy (ended), Spain (ended).
Therapeutic area(s): Diseases [C] - Neoplasms [C04]
Gender: Female, Male. Age: 18-64 years, 65+ years. Enrolment: 76.
Status: Ended. End date (EU): 2025-06-13. Decision date: 2024-07-01. Results received: No. Last updated: 2025-01-02.
Decision dates by country: ES: 2024-07-01, SE: 2024-07-04, DE: 2024-07-03, FR: 2024-07-04, PL: 2024-07-05, IT: 2024-07-02

Condition(s): Advanced ccRCC
Product: Belzutifan, PALBOCICLIB

Primary endpoint: Part 1 - Number of Participants Who Experience at Least One Dose-limiting Toxicity (DLT), Part 1 - Number of Participants Who Experience at Least One Adverse Event (AE), Part 1 - Number of Participants Who Discontinue Study Treatment Due to an AE, Part 2 - Objective Response Rate (ORR) Per Response Evaluation Criteria in Solid Tumors Version 1.1 (RECIST 1.1) as Assessed by Investigator
Endpoint(s): Part 2 - Clinical Benefit Rate (CBR) Per Response Evaluation Criteria in Solid Tumors Version 1.1 (RECIST 1.1) as Assessed by Investigator, Part 2 - Duration of Response (DOR) Per Response Evaluation Criteria in Solid Tumors Version 1.1 (RECIST 1.1) as Assessed by Investigator, Part 2 - Progression-Free Survival (PFS) According to Response Evaluation Criteria in Solid Tumors Version 1.1 (RECIST 1.1) as Assessed by Investigator, Part 2 - Overall Survival (OS), Part 2 - Number of Participants Who Experience at Least One Adverse Event (AE), Part 2 - Number of Participants Who Discontinue Study Treatment Due to an AE

Source: https://euclinicaltrials.eu/ctis-public/view/2023-504963-17-00